EU clinical trial 2024-518473-34-00: A Randomized, Open-label Phase 3 Study of Carfilzomib, Lenalidomide, and Dexamethasone Versus Bortezomib, Lenalidomide and Dexamethasone (KRd vs. VRd) in Patients With Newly Diagnosed Multiple Myeloma (COBRA)
Protocol code: PMC010
Sponsor: Polish Myeloma Consortium (Patient organisation/association). Phase: Therapeutic confirmatory (Phase III). Countries: Poland (ongoing, recruitment ended), Finland (ongoing, recruitment ended), Norway (ongoing, recruitment ended).
Therapeutic area(s): Diseases [C] - Neoplasms [C04]
Gender: Female, Male. Age: 18-64 years, 65+ years. Enrolment: 233.
Status: Ongoing, recruitment ended. Start date (EU): 2019-11-20. Decision date: 2024-12-11. Results received: No. Last updated: 2025-04-02.
Decision dates by country: NO: 2024-12-11, FI: 2024-12-12, PL: 2024-12-16

Condition(s): Multiple Myeloma
Product: Revlimid 20 mg hard capsules, Revlimid 10 mg hard capsules, Revlimid 15 mg hard capsules, Revlimid 25 mg hard capsules, Revlimid 15 mg hard capsules, Kyprolis 60 mg powder for solution for infusion, Revlimid 5 mg hard capsules, Revlimid 10 mg hard capsules, VELCADE 3.5 mg powder for solution for injection, DEXAMETHASONE, Revlimid 5 mg hard capsules, Revlimid 20 mg hard capsules, Revlimid 25 mg hard capsules

Primary endpoint: The MRD-negative complete response status at 12 months by NGS and PFS defined as the time to progressive disease or death as defined by IMWG criteria
Endpoint(s): The MRD-negative status in each study arm at 8and 24 months, Duration of MRD-negative status., MRD-negative complete response, Comparing rate of PR or better, VGPR or better, CR or better, or sCR at 8, 12, 24, 36, 48, and 60 months and as best response between the two arms, Determine rates of improvement of the depth of response by at least one category according to IMWG response criteria. (For example, an improvement from very good partial response (VGPR) to near complete response (nCR) or better than nCR including conversion from CR to MRD negative disease [overall response]) at specified landmark timepoints., To compare overall survival., Safety and tolerability of KRd vs. VRd

Source: https://euclinicaltrials.eu/ctis-public/view/2024-518473-34-00